EU clinical trial 2026-525608-85-00: The GranStone Trial - Prevention of Kidney Stones due to Paraffin Oil Induced Granuloma
Sponsor: Region Hovedstaden (Hospital/Clinic/Other health care facility). Phase: Phase II and Phase III (Integrated). Countries: Denmark (authorised, recruitment pending).
Therapeutic area(s): Diseases [C] - Musculoskeletal Diseases [C05]; Diseases [C] - Hormonal diseases [C19]; Diseases [C] - Male Urogenital Diseases [C12]
Gender: Male. Age: 18-64 years, 65+ years. Enrolment: 100.
Status: Authorised, recruitment pending. Decision date: 2026-05-11. Results received: No. Last updated: 2026-05-11.

Condition(s): Paraffin Oil Induced Granulomatous Disease
Product: EMPAGLIFLOZIN, LOSARTAN

Primary endpoint: Image verified new or increased nephrolithiasis or nephrocalcinosis (from 1-24 months).
Endpoint(s): Change in estimated glomerular filtration rate (eGFR)., Change in calcium homeostasis after 12 and 24 months defined by: 1A Change in p-Calcium ion concentration; 1B Change in p-PTH concentration; 1C Change in urine calcium excretion., Change in average daily prednisolone dosage based on cumulative average predniso-lone dose., Change in p-creatinine, eGFR and BUN., Change in p-IL-2R and/or p-ACE., Change in physical- and mental health scores (SF-36)., Change in mineral homeostasis in serum and urine (albumin, phosphate, magnesium, iron, ferritin, FGF23, Klotho)., Changes in serum vitamin D metabolites (25OHD,24,25(OH)2D3, 1,25(OH)2D)., Change in urine Na, Ka, pH, citrate, oxalate, bicarbonate, uric acid, urea., Changes in left ventricular ejection fraction (LVEF) and other indices of cardiac func-tion as measured by transthoracic echocardiography., Incident or worsening signs of: Systolic- and/or diastolic dysfunction, left ventricular hypertrophy, structural heart disease including valvular pathology., Changes in CT Hounsfield Units in the femoral neck and lumbar vertebrae., Changes Coronary Artery Calcium Score on CT-scan., Change in BMD, fat- and lean mass evaluated by DXA-scan., Changes in self-reported kidney stones

Source: https://euclinicaltrials.eu/ctis-public/view/2026-525608-85-00